EU clinical trial 2023-508248-23-00: A randomised, double-blind, placebo-controlled, multicentre, Phase 3 study evaluating efficacy and safety of lanifibranor followed by an active treatment extension in adult patient with non-cirrhotic non-alcoholic steatohepatitis (NASH) and fibrosis 2 (F2)/fibrosis 3 (F3) stage of liver fibrosis
Protocol code: 337HNAS20011
Sponsor: Inventiva (Pharmaceutical company). Phase: Therapeutic confirmatory (Phase III). Countries: Bulgaria (ongoing, recruitment ended), Germany (ongoing, recruitment ended), Spain (ongoing, recruitment ended), Poland (ongoing, recruitment ended), Portugal (ongoing, recruitment ended), Italy (ongoing, recruitment ended), Netherlands (ongoing, recruitment ended), Belgium (ongoing, recruitment ended), France (ongoing, recruitment ended), Czechia (ended), Hungary (ongoing, recruitment ended).
Therapeutic area(s): Diseases [C] - Nutritional and Metabolic Diseases [C18]
Gender: Female, Male. Age: 18-64 years, 65+ years. Enrolment: 236.
Start date (EU): 2021-11-26. Decision date: 2024-08-22. Results received: No. Last updated: 2026-05-26.
Decision dates by country: IT: 2024-08-27, CZ: 2024-08-27, HU: 2024-08-26, BG: 2024-08-23, NL: 2024-08-23, ES: 2024-08-26, BE: 2024-08-23, PL: 2024-08-23, DE: 2024-08-26, FR: 2024-08-22, PT: 2024-08-23

Condition(s): Non-alcoholic steatohepatitis (NASH)
Product: PL1, Lanifibranor clinical, Lactose monohydrate, microcrystalline cellulose, pre gelatinized starch, magnesium stearate, opadry™ II 85F18422, purified water

Primary endpoint: Resolution of NASH and improvement of fibrosis at Week 72, defined by NASH CRN scores for ballooning of 0 and inflammation of 0 to 1, and fibrosis score ≥1 stage decrease compared to Baseline.
Endpoint(s): Resolution of NASH and no worsening of fibrosis at Week 72, defined by NASH CRN scores for ballooning of 0, inflammation of 0 to 1, and no increase in fibrosis score when compared to Baseline; Improvement of fibrosis and no worsening of NASH at Week 72, defined by a decrease in NASH CRN fibrosis score ≥1 stage from Baseline and no increase in scores for ballooning, inflammation, or steatosis

Source: https://euclinicaltrials.eu/ctis-public/view/2023-508248-23-00